EU clinical trial 2024-518167-35-01: Phase II, multicentre, randomised, open-label trial with MAP +/- denosumab regimen for the treatment of patients with metastatic osteosarcoma
Protocol code: AIEOP-ISG OsM+
Sponsor: Associazione Italiana Ematologia Oncologia Pediatrica (Hospital/Clinic/Other health care facility). Phase: Therapeutic exploratory (Phase II). Countries: Italy (ongoing, recruiting).
Therapeutic area(s): Diseases [C] - Neoplasms [C04]
Gender: Female, Male. Age: 0-17 years, 18-64 years. Enrolment: 88.
Status: Ongoing, recruiting. Start date (EU): 2025-12-19. Decision date: 2024-12-16. Results received: No. Last updated: 2025-08-07.

Condition(s): Patients with Metastatic Osteosarcoma
Product: Metotressato Teva 25 mg/ml soluzione iniettabile, Doxorubicina Teva 2 mg/ml concentrato per soluzione per infusione, XGEVA 120 mg solution for injection, CISPLATINO Pfizer 100 mg/100 ml soluzione per infusione

Primary endpoint: The primary end-point is 3-year Event Free Survival (EFS)

Source: https://euclinicaltrials.eu/ctis-public/view/2024-518167-35-01